EU clinical trial 2023-508298-10-00: Haemodynamic Effects of Dobutamine in Patients with Wild-type Transthyretin Amyloid Cardiomyopathy (ATTRwt)
Sponsor: Region Midtjylland (Hospital/Clinic/Other health care facility). Phase: Therapeutic exploratory (Phase II). Countries: Denmark (ongoing, recruiting).
Therapeutic area(s): Diseases [C] - Cardiovascular Diseases [C14]
Gender: Female, Male. Age: 65+ years. Enrolment: 15.
Status: Ongoing, recruiting. Start date (EU): 2024-04-01. Decision date: 2023-12-08. Results received: No. Last updated: 2026-04-19.

Condition(s): Wild-type Transthyretin Amyloid Cardiomyopathy (ATTRwt)
Product: Dobutrex, koncentrat til infusionsvæske, opløsning, Natriumklorid ”B. Braun”, Glukose Isotonisk "SAD", injektions- og infusionsvæske, opløsning

Primary endpoint: changes in CO evaluated by the thermodynamic invasive method.
Endpoint(s): Changes in SVI measured invasively, Changes in PAWP and mPAP, Changes in LVEF and LV-global longitudinal strain (LV-GLS), Correlation between echo- and invasive measured SVI, and CO, Rate of complications/symptomatic side effects

Source: https://euclinicaltrials.eu/ctis-public/view/2023-508298-10-00